EU clinical trial 2025-520639-17-00: Prostate Androgen Response Investigation using a Stratification BIOmarker - PARIS-BIO Predicting prostate cancer downstageing by neoadjuvant Darolutamide with PCAI ImmunoScore in a non-randomised open label prospective trial.
Protocol code: PARIS-BIO 1.0
Sponsor: Karolinska University Hospital (Hospital/Clinic/Other health care facility). Phase: Therapeutic exploratory (Phase II). Countries: Sweden (ongoing, recruiting).
Therapeutic area(s): Diseases [C] - Neoplasms [C04]
Gender: Male. Age: 18-64 years, 65+ years. Enrolment: 100.
Status: Ongoing, recruiting. Start date (EU): 2025-11-12. Decision date: 2025-06-19. Results received: No. Last updated: 2026-04-16.

Condition(s): High-risk localized or locally advanced prostate adenocarcinoma
Product: NUBEQA 300 mg film-coated tablets

Primary endpoint: Association of pathological response (MRD) with the pre-treatment genomic biomarker PCAI ImmunoScore
Endpoint(s): The associaton of the PCAI ImmunoScore with pathologic complete response (pCR), The associaton of the PCAI ImmunoScore with pT-stage at final pathology, The associaton of the PCAI ImmunoScore with size of largest cross-sectional dimension of residual tumour on pathology, The associaton of the PCAI ImmunoScore with number of resection specimen slides in which the tumour can be seen on pathology, The associaton of the PCAI ImmunoScore with MRI assessment of changes in tumour size, cross sectional dimension, volume, and EPE, The associaton of the PCAI ImmunoScore with blood PSA concentration during treatment, Correlation between Pathological response and MRI response., Hormonal side effects during and after treatment, measured through AE/SAE registration and repeated validated questionnaires as well as changes in blood testosterone concentration, Post- surgical functional outcomes (erectile function and urinary continence) in the cohort measured through questionnaires, The association of the PCAI ImmunoScore with Residual Cancer Burden (RCB), defined as residual tumour volume in mm³ corrected for tumour cellularity.

Source: https://euclinicaltrials.eu/ctis-public/view/2025-520639-17-00